EU clinical trial 2023-504378-39-00: First-in-human Phase 1 Study to Assess the Safety, Tolerability, and Immunogenicity of the Adjuvanted Universal Influenza Vaccine “fH1/DSP-0546LP” in Healthy Adults
Protocol code: R2411201
Sponsor: Sumitomo Pharma Co. Ltd. (Pharmaceutical company). Phase: Human Pharmacology (Phase I)- First administration to humans. Countries: Belgium (ended).
Therapeutic area(s): Diseases [C] - Virus Diseases [C02]
Gender: Female, Male. Age: 18-64 years. Enrolment: 144.
Status: Ended. Start date (EU): 2024-06-26. End date (EU): 2026-03-31. End date: 2026-04-01. Decision date: 2024-05-03. Results received: No. Last updated: 2024-11-29.

Condition(s): Influenza

Source: https://euclinicaltrials.eu/ctis-public/view/2023-504378-39-00